EU clinical trial 2024-512369-14-00: A multicenter, open-label, non-comparative, single-arm, phase II trial of datopotamab deruxtecan for non-squamous non-small cell lung cancer patients with active brain metastases (The TUXEDO-5 Study)
Protocol code: MEDOPP750
Sponsor: Medica Scientia Innovation Research S.L. (Pharmaceutical company). Phase: Therapeutic exploratory (Phase II). Countries: Spain (not authorised), Austria (not authorised).
Therapeutic area(s): Diseases [C] - Neoplasms [C04]
Gender: Female, Male. Age: 18-64 years, 65+ years. Enrolment: 20.
Status: Not authorised. Decision date: 2025-07-14. Results received: No. Last updated: 2025-07-14.
Decision dates by country: AT: 2025-07-14, ES: 2025-07-14

Condition(s): Non-small cell lung cancer (NSCLC).
Product: Datopotamab deruxtecan, Polaramine 5 mg/ml solución inyectable, Paracetamol Sandoz 500 mg – Tabletten, Dibondrin Ampullen, Dibondrin Dragees, Polaramine 2 mg comprimidos, Paracetamol Kabi 10 mg/ml solución para perfusión

Primary endpoint: ORR-IC, defined as the rate of patients with complete response (CR) or partial response (PR) for IC lesions determined locally by investigator, using RANO-BM criteria.
Endpoint(s): ORR, defined as the rate of patients with CR or PR determined locally by investigator as per RECIST v.1.1 for EC lesions (ORR-EC) and overall lesions., PFS, defined as the period from treatment initiation to the first occurrence of disease progression or death from any cause, whichever occurs first. It will be determined locally by investigator as per RANO-BM for IC lesions and RECIST v.1.1 for EC and overall lesions., CBR, defined as the rate of patients with objective response (CR or PR), or stable disease for at least 24 weeks, as per RANO-BM for IC lesions and RECIST v.1.1 for EC and overall lesions., DCR, defined as the rate of patients with objective response (CR or PR), or stable disease (SD), as per RANO-BM for IC and RECIST v.1.1 for EC and overall lesions., TTR, defined as the period from the treatment initiation to time of the first objective tumor response (tumor shrinkage of ≥ 30%) observed for patients who achieved a CR or PR, as per RANO-BM for IC lesions and RECIST v.1.1 for EC and overall lesions., DoR, defined as the period from the first occurrence of a documented objective response to disease progression or death from any cause, observed for patients who achieved a CR or PR, as per RANO-BM for IC and RECIST v.1.1 for EC and overall lesions., OS, defined as the period from treatment initiation to death from any cause or last available follow-up., Best percentage of change in tumor burden as per RANO-BM for IC lesions and RECIST v.1.1 for EC and overall measurable lesions., Neurologic function as per NANO scale., Safety endpoints: Safety and tolerability as per NCI-CTCAE v.5.0 and Corneal Toxicity Severity Grading Scale., Safety endpoints: Assessment of QoL and neurocognitive function with EORTC QLQ-C30 and the brain specific tool (EORTC QLQ-BN20)., Exploratory endpoints: Exploratory endpoints are still to be defined but can include (but are not limited to): Association of clinical outcomes, safety and/or tolerability profile with mutation profiling, copy number variability, gene expression, multiplex assays, proteomic analyses, digital pathology, immunohistochemistry, taxonomic or functional analyses performed on tissue and/or liquid biopsy samples., Exploratory endpoints: Exploratory endpoints are still to be defined but can include (but are not limited to): Association of treatment efficacy and/or safety outcomes with radiological imaging biomarkers in all patients.

Source: https://euclinicaltrials.eu/ctis-public/view/2024-512369-14-00